EU clinical trial 2025-520685-21-00: Effect of treatment of the cholinergic precursor Choline Alfoscerate in mild cognitive dysfunction
Sponsor: Universita' Degli Studi Di Camerino (Educational Institution). Phase: Therapeutic use (Phase IV). Countries: Italy (authorised, recruitment pending).
Therapeutic area(s): Diseases [C] - Nervous System Diseases [C10]
Gender: Female, Male. Age: 65+ years. Enrolment: 60.
Status: Authorised, recruitment pending. Decision date: 2025-01-31. Results received: No. Last updated: 2025-09-11.

Condition(s): Mild cognitive dysfunction
Product: Composition (except active ingredient): Methylparaben Ph. Eur. Propylparaben Ph. Eur. Saccharine Sodium Ph. Eur. Orange Flavor 1111853 Purified water q.s., GLIATILIN 600 mg flaconcini

Primary endpoint: The slowing and / or stability of hippocampal atrophy, entorhinal cortex, neocortex and ventricular dilation through the use of a cholinergic precursor (choline alfoscerate) in patients with mild cognitive dysfunction with associated vascular damage will be measured using the evaluation of the brain atrophy, mainly of hippocampal area, studied by segmentation of the images obtained by MRI.
Endpoint(s): The stability and/or improvement of cognitive abilities will be assessed through the use of neuropsychological scales that will evaluate the cognitive performance of patients (executive, memory, visual-constructive, linguistic and attentional functions) at the end of the study compared to the baseline visit. Functional performances and changes in mood and motivation will be evaluated with specific neuropsychological tests.

Source: https://euclinicaltrials.eu/ctis-public/view/2025-520685-21-00